EU clinical trial 2024-511196-15-00: A Phase I, open-label, randomized, two period, cross-over study in healthy subjects to assess the bioavailability of different formulations of deucrictibant administered as single dose under fasting condition.
Protocol code: PHA022121-C020
Sponsor: Pharvaris Netherlands B.V. (Pharmaceutical company). Phase: Human Pharmacology (Phase I)- Other. Countries: Hungary (ended).
Therapeutic area(s): Diseases [C] - Skin and Connective Tissue Diseases [C17]; Diseases [C] - Immune System Diseases [C20]; Diseases [C] - Congenital, Hereditary, and Neonatal Diseases and Abnormalities [C16]
Gender: Female, Male. Age: 18-64 years. Enrolment: 14.
Status: Ended. Start date (EU): 2024-06-13. End date (EU): 2024-07-26. Decision date: 2024-05-13. Results received: No. Last updated: 2024-05-13.

Condition(s): Hereditary angioedema (HAE)

Source: https://euclinicaltrials.eu/ctis-public/view/2024-511196-15-00